EU clinical trial 2024-511885-35-00: TELeMAC - Comparative multicenter randomized study of aflibercept versus placebo in macular telangiectasia type 1
Sponsor: Centre Hospitalier Universitaire De Dijon (Hospital/Clinic/Other health care facility). Phase: Therapeutic confirmatory (Phase III). Countries: France (ended).
Therapeutic area(s): Diseases [C] - Eye Diseases [C11]
Gender: Female, Male. Age: 18-64 years, 65+ years. Enrolment: 46.
Status: Ended. Start date (EU): 2019-07-03. End date (EU): 2025-03-26. Decision date: 2024-05-28. Results received: No. Last updated: 2025-07-24.

Condition(s): macular telangiectasia type 1
Product: Eylea 40 mg/mL solution for injection in a vial, Eylea 40 mg/mL solution for injection in pre-filled syringe

Primary endpoint: Change in central retinal thickness between M0 and M6, measured by SD-OCT
Endpoint(s): Evolution between M0 and M6 of visual acuity measured on the ETDRS scale, Evolution between M0 and M6 of retinal volume measured by SD-OCT, Evolution between M0 and M6 of perifoveolar capillary density in the superficial and deep capillary plexus measured by OCTA, Evolution between M0 and M6 of number of abnormal microvascular lesions in the superficial and deep capillary plexus measured by OCTA, Ocular safety (sustainable elevation of ocular pressure, cataract, intraocular inflammation, infectious endophthalmitis, retinal detachment, retinal tear, vitreous or subretinal hemorrhage

Source: https://euclinicaltrials.eu/ctis-public/view/2024-511885-35-00